EU clinical trial 2024-519960-42-00: EPIK-P4: A Phase II single arm study to assess the efficacy, safety and pharmacokinetics of alpelisib (BYL719) in pediatric and adult patients with PIK3CA-related overgrowth spectrum (PROS)
Protocol code: CBYL719F12202
Sponsor: Novartis Pharma AG (Pharmaceutical company). Phase: Therapeutic exploratory (Phase II). Countries: Italy (ongoing, recruiting), Netherlands (authorised, recruitment pending), Belgium (ongoing, recruiting), Spain (ongoing, recruiting), Austria (ongoing, recruiting), Germany (ongoing, recruiting), France (ongoing, recruiting).
Therapeutic area(s): Diseases [C] - Congenital, Hereditary, and Neonatal Diseases and Abnormalities [C16]
Gender: Female, Male. Age: 0-17 years, 18-64 years, 65+ years. Enrolment: 72.
Start date (EU): 2025-12-11. Decision date: 2025-10-20. Results received: No. Last updated: 2026-05-13.
Decision dates by country: IT: 2025-10-21, ES: 2025-10-20, DE: 2025-10-21, AT: 2025-10-20, BE: 2025-10-20, FR: 2025-10-20, NL: 2025-10-22

Condition(s): PIK3CA-Related Overgrowth Spectrum (PROS)
Product: BYL719, BYL719, BYL719, BYL719, BYL719

Primary endpoint: Proportion of participants achieving confirmed objective response at any time, defined as achieving radiological response confirmed by a subsequent assessment performed at least after 4 weeks.
Endpoint(s): Changes from baseline in PROS lesion volumes(as assessed by BIRC) in the: • Sum of target lesion volume. • Sum of MRI-measurable non-target lesion volume. • Sum of all MRI-measurable (target and nontarget)lesion volume. Change from baseline in other non-target lesions(by BIRC). Appearance of new lesions (by BIRC)., Proportion of participants with a radiological response at scheduled protocol timepoints, Duration of response defined as the time from the first documented confirmed objective response until progression of any PROS lesion (by BIRC) or death due to any cause or rescue surgery for any PROS lesion, whichever comes first, Alpelisib plasma concentration at selected time points., Change in scores from Brief Pain Inventory (BPI) items, or Wong-Baker Faces Scale (age appropriate), and Patient Global Impression of Symptom Severity (PGI-S)., Time to treatment failure (TTF) is defined as the time from alpelisib treatment start date until disease progression confirmed by BIRC, death, rescue surgery for any PROS lesion or discontinuation of the study treatment due to any reason other than technical problems or study termination by the sponsor., Overall clinical response as assessed by Investigator, Change from baseline in PROS-related symptoms and in complications/comorbidities among participants with symptoms and complications/comorbidities present at baseline., Number/percentage of participants with healthcare visits/hospitalized due to PROS; number of hospitalizations. Number/percentage of participants with surgeries required to manage PROS; number of surgeries., Incidence, type and severity of treatment-emergent adverse events per CTCAE v4.03 criteria and other safety data including changes in laboratory values, vital signs, assessments of cardiac function, growth, bone/dental development and sexual maturation (for applicable age).

Source: https://euclinicaltrials.eu/ctis-public/view/2024-519960-42-00